EU clinical trial 2023-505762-29-00: Phase III, randomized, observer-blind, placebo-controlled, multi-center, multinational study to evaluate the efficacy, immunogenicity, and safety of a Respiratory Syncytial Virus vaccine in infants and toddlers (PEARL)
Protocol code: VAD00004
Sponsor: Sanofi Pasteur Inc. (Pharmaceutical company). Phase: Therapeutic confirmatory (Phase III). Countries: Germany (ended), Spain (ended), Finland (ended).
Therapeutic area(s): Diseases [C] - Virus Diseases [C02]
Gender: Female, Male. Age: 0-17 years. Enrolment: 340.
Status: Ended. Start date (EU): 2024-08-09. End date (EU): 2026-05-15. End date: 2026-05-15. Decision date: 2024-05-06. Results received: No. Last updated: 2026-03-30.
Decision dates by country: DE: 2024-05-13, ES: 2024-05-07, FI: 2024-05-06

Condition(s): Virus diseases
Product: Live Attenuated Respiratory Syncytial Virus (RSV) ∆NS2/∆1313/I1314L vaccine, Matched

Primary endpoint: Occurrence of LRTD (during RSV Season 1) associated with any RT PCR confirmed RSV strain > 21 days post-dose 2
Endpoint(s): Occurrence of URTD (during RSV Season 1) associated with any RT PCR confirmed RSV strain > 21 days post-dose 2, Occurrence of LRTD (during RSV Season 1) associated with any RT PCR confirmed RSV strain leading to hospitalization > 21 days post-dose 2, Occurrence of severe LRTD (during RSV Season 1) associated with any RT PCR confirmed RSV strain > 21 days post-dose 2, Occurrence of urgent care visits, associated with an episode of LRTD over RSV Season 1, associated with any RT-PCR confirmed RSV strain > 21 days post-dose 2, Occurrence of ARD (during RSV Season 1) associated with any RT-PCR confirmed RSV strain > 21 days post-dose 2, Occurrence of hospitalizations, associated with an episode of ARD over RSV Season 1, associated with any RT-PCR confirmed RSV strain > 21 days post dose 2, Occurrence of urgent care visits, associated with an episode of ARD over RSV Season 1, associated with any RT-PCR confirmed RSV strain > 21 days post-dose 2, Occurrence of LRTD (during RSV Season 1) associated with an RT-PCR confirmed RSV A or B strain > 21 days post-dose 2, Occurrence of URTD (during RSV Season 1) associated with an RT-PCR confirmed RSV A or B strain > 21 days post-dose 2, Occurrence of ARD (during RSV Season 1) associated with an RT PCR confirmed RSV A or B strain > 21 days post-dose 2, Occurrence of LRTD (during RSV Season 1) associated with any RT PCR confirmed RSV strain > 21 days post-dose 1, Occurrence of URTD (during RSV Season 1) associated with any RT PCR confirmed RSV strain > 21 days post-dose 1, Occurrence of ARD (during RSV Season 1) associated with any RT PCR confirmed RSV strain > 21 days post-dose 1, Occurrence of LRTD (during RSV Season 1) associated with any RT PCR confirmed RSV strain > 21 days post-dose 2, in RSV-exposed participants, Occurrence of URTD (during RSV Season 1) associated with any RT PCR confirmed RSV strain > 21 days post-dose 2, by baseline serostatus, Occurrence of ARD (during RSV Season 1) associated with any RT PCR confirmed RSV strain > 21 days post-dose 2, by baseline serostatus, Occurrence of LRTD (during RSV Season 2), associated with any RT-PCR confirmed RSV strain, Occurrence of URTD (during RSV Season 2), associated with any RT-PCR confirmed RSV strain, Occurrence of ARD (during RSV Season 2), associated with any RT PCR confirmed RSV strain, Occurrence of LRTD (during RSV Season 2), associated with any RT PCR confirmed RSV strain, by baseline serostatus, Occurrence of URTD (during RSV Season 2), associated with any RT PCR confirmed RSV strain, by baseline serostatus, Occurrence of ARD (during RSV Season 2), associated with any RT PCR confirmed RSV strain, by baseline serostatus, Presence of solicited administration site reactions within 21 days after each vaccination, Presence of solicited systemic reactions within 21 days after each vaccination, Presence of unsolicited systemic adverse events (AEs) reported in the 30 minutes after each vaccination, Presence of unsolicited AEs within 28 days after each vaccination, Presence of medically attended adverse events MAAEs throughout the study, Presence of serious adverse events (SAEs) throughout the study, Presence of adverse events of special interest (AESIs) throughout the study, RSV A serum neutralizing antibody titers at D01, RSV B serum neutralizing antibody titers at D01, RSV A serum neutralizing antibody titers at 28 days post-dose 2, RSV B serum neutralizing antibody titers at 28 days post-dose 2, RSV serum anti-F Immunoglobulin A (IgA) Electrochemiluminescence (ECL) antibody titers at D01, RSV serum anti-F IgG ECL antibody titers at D01, RSV serum anti-F Immunoglobulin A (IgA) ECL antibody titers at 28 days post-dose 2, RSV serum anti-F IgG ECL antibody titers at 28 days post-dose 2

Source: https://euclinicaltrials.eu/ctis-public/view/2023-505762-29-00